EU clinical trial 2023-508165-33-00: An Open-Label Extension Study to Assess the Long-Term Safety and Tolerability of ZYN002 Administered as a Transdermal Gel to Children, Adolescents and Young Adults with Fragile X Syndrome
Protocol code: ZYN2-CL-017
Sponsor: Harmony Biosciences Management Inc. (Pharmaceutical company). Phase: Therapeutic confirmatory (Phase III). Countries: Ireland (ended).
Therapeutic area(s): Diseases [C] - Congenital, Hereditary, and Neonatal Diseases and Abnormalities [C16]
Gender: Female, Male. Age: 0-17 years, 18-64 years. Enrolment: 5.
Status: Ended. Start date (EU): 2024-07-26. End date (EU): 2025-11-17. End date: 2026-04-22. Decision date: 2024-05-03. Results received: No. Last updated: 2025-10-10.

Condition(s): Fragile X Syndrome (FXS)
Product: ZYN002 Transdermal Gel Cannabidiol (CBD)

Primary endpoint: Safety assessments will include collection of AEs including seizure assessment if applicable, physical and neurological examinations, 12-lead ECG, safety laboratory assessments (hematology, chemistry, reproductive hormone, prolactin tests, and urinalysis), vital signs, C-SSRS, and findings from the skin irritation checks following treatment.
Endpoint(s): Change from Baseline (last assessment prior to the first dose of ZYN002) in the ABC-CFXS subscale scores (Social Avoidance, Irritability, Socially Unresponsive/Lethargic, Stereotypy, Inappropriate Speech, and Hyperactivity) at Months 1, 6, 12, 18, 24, 30, 36, 42, and 48/ET., CGI-I at Months 1, 6, 12, 24, 36, and 48/ET., Percent of patients who have ≥25% improvement from Baseline in ABC-CFXS Social Avoidance subscale score at Months 1, 6, 12, 18, 24, 30, 36, 42, and 48/ET., Percent of patients who have ≥25% improvement from Baseline in ABC-CFXS Irritability subscale score at Months 1, 6, 12, 18, 24, 30, 36, 42, and 48/ET., Response rate for patients having both ≥25% improvement from Baseline in ABC-CFXS Social Avoidance subscale score AND improved on CGI-I scale at Months 1, 6, 12, 18, 24, 30, 36, 42, and 48/ET., Response rate for patients having both ≥25% improvement from Baseline in ABC CFXS Irritability subscale score AND improved on CGI-I scale at Months 1, 6, 12, 18, 24, 30, 36, 42, and 48/ET., Percent of patients indicating improvement on the CGI-I (dichotomized) scale at Months 1, 6, 12, 24, 36, and 48/ET., Change from Baseline in CGI-S at Months 1, 6, 12, 24, 36, and 48/ET., Change from Baseline/Day 1 in Caregiver Global Impression of Severity at Months 6, 12, 24, 36, and 48/ET., Caregiver Global Impression of Change at Months 6, 12, 24, 36, and 48/ET., Change from Baseline in PedsQL at Month 6, and Month 12

Source: https://euclinicaltrials.eu/ctis-public/view/2023-508165-33-00